EU clinical trial 2022-501260-18-00: A Phase 2, Open-Label, Multicenter, Basket Study Evaluating the Safety and Efficacy of Brexucabtagene Autoleucel in Adults with Rare B-cell Malignancies (ZUMA 25) – Substudy B – Relapsed/Refractory Richter Transformation (RT)
Protocol code: KT-US-568-0138-B
Sponsor: Kite Pharma Inc. (Pharmaceutical company). Phase: Therapeutic exploratory (Phase II). Countries: France (ended), Germany (ended), Spain (ended), Sweden (ended), Italy (ended), Netherlands (ended), Austria (ended).
Therapeutic area(s): Diseases [C] - Neoplasms [C04]
Gender: Female, Male. Age: 18-64 years, 65+ years. Enrolment: 35.
Status: Ended. Start date (EU): 2023-04-14. End date (EU): 2025-01-27. End date: 2025-01-28. Decision date: 2023-02-13. Results received: Yes. Last updated: 2025-02-21.
Decision dates by country: AT: 2023-02-20, SE: 2023-02-13, NL: 2023-02-14, FR: 2023-02-14, ES: 2023-02-13, DE: 2023-04-25, IT: 2023-02-14

Condition(s): Relapsed/refractory Richter Transformation (RT)
Product: IMBRUVICA 140 mg hard capsules, VINCRISTINE, FLUDARABINE, PREDNISOLONE, IFOSFAMIDE, METHYLPREDNISOLONE, ETOPOSIDE, DOXORUBICIN, MESNA, CYCLOPHOSPHAMIDE, DEXAMETHASONE, OXALIPLATIN, Tecartus 0.4 – 2 × 108 cells dispersion for infusion, GEMCITABINE, CARBOPLATIN, RITUXIMAB

Primary endpoint: The primary endpoint of ZUMA-25 as per the master protocol is response rates by central assessment as defined in each substudy. The primary end point of Substudy B (RT) is ORR, defined as the proportion of subjects who achieve a best response of either complete response (CR) or partial response (PR)., Response will be determined by central assessment per the Lugano Classification (Cheson et al 2014).
Endpoint(s): The secondary endpoints of ZUMA-25 as per the master protocol are: • CR rate by central assessment as defined in each substudy, • Duration of Response, • Overall Survival, • Progression-free survival, • Time to next treatment defined as the time from enrollment (for Full Analysis Set [FAS]) or brexucabtagene autoleucel infusion (for modified intention to treat [mITT]) to the initiation of subsequent anticancer therapy/treatment, • Time to first response from brexucabtagene autoleucel infusion to the first response as defined in the substudy, Substudy B (RT) specific secondary endpoints are:, •ORR, defined as the proportion of subjects who achieve a best response of either CR or PR. Response will be determined by investigator assessment per the Lugano Classification, •ORR, defined as the proportion of subjects who achieve a best response of either CR or PR by central assessment per the Lugano Classification, in subgroups by clonal relationship to the underlying CLL. Clonality will be assessed by central assessment, •ORR, defined as the proportion of subjects who achieve a best response of either CR, CR with incomplete marrow recovery (CRi), or PR per International Workshop on Chronic Lymphocytic Leukemia (IWCLL) 2018 criteria.

Source: https://euclinicaltrials.eu/ctis-public/view/2022-501260-18-00